EU clinical trial 2025-521489-80-00: A PHASE II TRIAL EVALUATING THE SAFETY AND EFFICACY OF THE COMBINATION OF ZIMBERELIMAB, DOMVANALIMAB, AND SACITUZUMAB GOVITECAN AS FIRST-LINE THERAPY FOR PD-L1 POSITIVE ADVANCED TRIPLE-NEGATIVE BREAST CANCER (The ADJUNCT Study)
Protocol code: MEDOPP0653
Sponsor: Medica Scientia Innovation Research S.L. (Pharmaceutical company). Phase: Therapeutic exploratory (Phase II). Countries: Spain (ended).
Therapeutic area(s): Diseases [C] - Neoplasms [C04]
Gender: Female, Male. Age: 18-64 years, 65+ years. Enrolment: 25.
Status: Ended. End date (EU): 2026-04-20. Decision date: 2025-12-09. Results received: No. Last updated: 2026-04-30.
Decision dates by country: ES: 2026-03-03

Condition(s): PD-L1 POSITIVE ADVANCED TRIPLE-NEGATIVE BREAST CANCER
Product: DOMVANALIMAB, Zimberelimab, Trodelvy 200 mg powder for concentrate for solution for infusion

Primary endpoint: ORR rate defined as the rate of patients with complete response (CR) or partial response (PR) as determined locally by the investigator in accordance RECIST v.1.1
Endpoint(s): PFS, defined as the period from treatment initiation to the first occurrence of disease progression or death from any cause, whichever occurs first, as determined locally by the investigator using RECIST v.1.1., OS, defined as the period from treatment initiation to death from any cause., CBR, defined as the rate of patients with objective response (CR or PR), or stable disease for at least 24 weeks, as determined locally by the investigator using RECIST v.1.1., DoR, defined as the period from the first occurrence of a documented objective response to disease progression or death from any cause, whichever occurs first, as determined locally by the investigator using RECIST v.1.1., TTR is defined as the period of time from the date of randomization until the first documentation of CR or PR as determined locally by the investigator using RECIST v.1.1., Best percentage of change from baseline in the size of target tumor lesions is defined as the biggest decrease, or smallest increase if no decrease is observed, as determined locally by the investigator using RECIST v.1.1.

Source: https://euclinicaltrials.eu/ctis-public/view/2025-521489-80-00